EU clinical trial 2024-514054-70-00: Dendritic cell therapy combined with surgery in mesothelioma (ENSURE)
Protocol code: 76712
Sponsor: Erasmus Universitair Medisch Centrum Rotterdam (Erasmus MC) (Hospital/Clinic/Other health care facility). Phase: Human Pharmacology (Phase I)- First administration to humans. Countries: Netherlands (ongoing, recruiting).
Therapeutic area(s): Diseases [C] - Neoplasms [C04]
Gender: Female, Male. Age: 18-64 years, 65+ years. Enrolment: 14.
Status: Ongoing, recruiting. Start date (EU): 2024-08-12. Decision date: 2024-08-12. Results received: No. Last updated: 2024-08-12.

Condition(s): Adult patients diagnosed with resectable epithelioid MPM, following first-line chemotherapy.

Source: https://euclinicaltrials.eu/ctis-public/view/2024-514054-70-00